EU clinical trial 2024-510807-13-00: A Phase II/III, randomised, double-blind, placebo-controlled trial to evaluate the efficacy and safety of oral controlled-ileocolonic-release nicotinamide (CICR-NAM) for induction and maintenance therapy in patients with mild to moderately active ulcerative colitis
Protocol code: ORNATUS 1
Sponsor: Universitaetsklinikum Schleswig-Holstein AöR (Hospital/Clinic/Other health care facility). Phase: Phase II and Phase III (Integrated). Countries: Germany (ongoing, recruiting).
Therapeutic area(s): Diseases [C] - Digestive System Diseases [C06]
Gender: Female, Male. Age: 18-64 years, 65+ years. Enrolment: 459.
Status: Ongoing, recruiting. Start date (EU): 2024-09-12. Decision date: 2024-04-09. Results received: No. Last updated: 2026-05-29.

Condition(s): ulcerative colitis
Product: CICR-NAM, CICR-NAM Placebo

Primary endpoint: Symptomatic remission and endoscopic response and/or histologic improvement at Week 12., Clinical remission at Week 52 (for patients with a constant Mayo ES = 1 from baseline, this requires an objective second marker of improvement (histologic improvement to RHI ≤ 4)).
Endpoint(s): Symptomatic remission at Week 52., Endoscopic remission at Week 52., Symptomatic response at Week 12., Endoscopic response and/or histologic improvement at Week 12., Clinical remission at Week 52 in responders at Week 12., Symptomatic remission at Week 12., Endoscopic healing at Week 52., Histologic improvement at Week 12.

Source: https://euclinicaltrials.eu/ctis-public/view/2024-510807-13-00